EU clinical trial 2024-517105-85-00: A Two-part, Randomized, Double-blind, Placebo-controlled, Parallel-group Phase 2 Study to Evaluate Impact of Sunobinop (V117957) on Alcohol Consumption (Part A) and Alcohol Craving (Part B) in Subjects Diagnosed with Moderate to Severe Alcohol Use Disorder and Seeking Treatment
Protocol code: SUN2023
Sponsor: Knoa Pharma LLC (Pharmaceutical company). Phase: Therapeutic exploratory (Phase II). Countries: Romania (ended).
Therapeutic area(s): Psychiatry and Psychology [F] - Mental Disorders [F03]
Gender: Female, Male. Age: 18-64 years, 65+ years. Enrolment: 100.
Status: Ended. Start date (EU): 2025-05-26. End date (EU): 2026-05-04. Decision date: 2025-05-07. Results received: No. Last updated: 2026-07-27.
Decision dates by country: RO: 2025-05-16

Condition(s): Alcohol use disorder (AUD).
Product: V117957 Tablets Placebo - The placebo formulation has the same qualitative composition as the corresponding active formulation of V117957 Tablets, with the absence of the API. The only difference in the dosage forms of V117957 Tablets and the placebo are that V117957 is replaced in the placebo tablet with an additional amount of microcrystalline cellulose., Sunobinop 1 mg, Sunobinop 2 mg, Sunobinop 0.5 mg

Primary endpoint: Percent heavy drinking days (HDD) as assessed using Timeline Followback interview.
Endpoint(s): Number of standard unit drinks as assessed using Timeline Followback interview., Percent of days drinking (PDD) as assessed using Timeline Followback interview., WHO Risk Level of alcohol consumption as assessed using Timelines Followback interview.

Source: https://euclinicaltrials.eu/ctis-public/view/2024-517105-85-00